EU clinical trial 2023-509863-26-00: Stop of proton-pump inhibitor treatment in patients with liver cirrhosis – a doubleblind, placebo-controlled trial (STOPPIT)
Protocol code: STOPPIT
Sponsor: University Medical Center Hamburg-Eppendorf (Hospital/Clinic/Other health care facility). Phase: Phase III and phase IV (Integrated). Countries: Germany (ongoing, recruiting).
Therapeutic area(s): Diseases [C] - Digestive System Diseases [C06]
Gender: Female, Male. Age: 18-64 years, 65+ years. Enrolment: 476.
Status: Ongoing, recruiting. Start date (EU): 2021-04-29. Decision date: 2024-06-12. Results received: No. Last updated: 2025-06-24.

Condition(s): Liver cirrhosis
Product: P-Tabletten weiß 7 mm Lichtenstein, Nexium mups 20 mg magensaftresistente Tabletten

Primary endpoint: Time to first unplanned re-hospitalization* or death within 12 months after randomization (composite endpoint). *Exception: expected re-hospitalization for paracentesis in patients with a history of refractory ascites (without any other complication of cirrhosis) during a period of 30 days.
Endpoint(s): Death (all-cause and liver-related)., Unplanned re-hospitalization., Any Infection and differentiated by site of infection (SBP, pneumonia, urinary tract infection, blood stream infection, Clostridium difficile-associated enterocolitis, Norovirus infection, Sars-CoV-2-infection)., Acute hepatic decompensation and ACLF., Upper and lower gastrointestinal bleeding event., Experimental Endpoint: Changes of intestinal microbiota between baseline and day 90.

Source: https://euclinicaltrials.eu/ctis-public/view/2023-509863-26-00